EU clinical trial 2024-517525-10-00: An Open-Label Phase 2 Study to Evaluate the Safety, Tolerability, and Effect on Albuminuria of MZE829 in Adults with Proteinuric Chronic Kidney Disease and the APOL1 High Risk Genotype
Protocol code: MZE829-201
Sponsor: Maze Therapeutics Inc. (Pharmaceutical company). Phase: Therapeutic exploratory (Phase II). Countries: France (ongoing, recruiting).
Therapeutic area(s): Phenomena and Processes [G] - Genetic Phenomena [G05]
Gender: Female, Male. Age: 18-64 years, 65+ years. Enrolment: 14.
Status: Ongoing, recruiting. Start date (EU): 2025-09-15. Decision date: 2025-06-25. Results received: No. Last updated: 2026-07-31.

Condition(s): APOL1 Kidney Disease (AKD)
Product: MZE829

Primary endpoint: Safety and tolerability based on incidence of adverse events (AEs), and changes in vital signs, clinical laboratory assessments, 12-lead electrocardiograms (ECGs)

Source: https://euclinicaltrials.eu/ctis-public/view/2024-517525-10-00